EU clinical trial 2024-517229-18-00: Aspirin versus Aspirin and Fondaparinux Prior to Early Invasive Strategy in Patients with NSTEMI
Sponsor: Region Midtjylland (Hospital/Clinic/Other health care facility). Phase: Phase III and phase IV (Integrated). Countries: Denmark (ongoing, recruiting).
Therapeutic area(s): Diseases [C] - Cardiovascular Diseases [C14]
Gender: Female, Male. Age: 18-64 years, 65+ years. Enrolment: 5076.
Status: Ongoing, recruiting. Start date (EU): 2025-04-30. Decision date: 2025-01-22. Results received: No. Last updated: 2026-06-17.

Condition(s): Non-ST-Elevation Myocardial Infarction (NSTEMI)
Product: ACETYLSALICYLIC ACID, FONDAPARINUX SODIUM, ACETYLSALICYLIC ACID, FONDAPARINUX SODIUM

Primary endpoint: Composite endpoint of: 30-day mortality, 30-day new MI and refractory ischemia resulting in acute CAG before scheduled
Endpoint(s): Composite of occurrence of death or new MI within 180 days, 1 year, 3 years, 5 years and 10 years., Incidence cerebrovascular accident (CVA) within 30 days including: Ischemic stroke and Transient ischemic attack (TIA), Length of hospital stay, Left ventricular ejection fraction (LVEF) at discharge

Source: https://euclinicaltrials.eu/ctis-public/view/2024-517229-18-00